EU clinical trial 2024-513079-42-00: SENTIRAD-1502 - RANDOMIZED STUDY COMPARING SENTINEL NODE (SN) POLICY TO CURRENT FRENCH INITIAL STAGING PROTOCOLS IN EARLY STAGE ENDOMETRIAL CARCINOMAS AT INTERMEDIATE AND HIGH RISK OF RECURRENCE
Protocol code: SENTIRAD-1502
Sponsor: Centre Oscar Lambret (Pharmaceutical company). Phase: Therapeutic confirmatory (Phase III). Countries: France (ongoing, recruitment ended).
Therapeutic area(s): Diseases [C] - Neoplasms [C04]
Gender: Female. Age: 65+ years. Enrolment: 262.
Status: Ongoing, recruitment ended. Start date (EU): 2015-11-19. Decision date: 2024-08-09. Results received: No. Last updated: 2026-04-30.

Condition(s): Intermediate-risk, high risk endometrial cancer
Product: TECHNETIUM (99MTC) RHENIUMSULFIDE COLLOID, TECHNETIUM (99MTC) NANOCOLLOID, PATENT BLUE, INDOCYANINE GREEN

Primary endpoint: Per-operative morbidity will be assessed during surgery according to the Oslo classification of intraoperative unfavourable incidents. Adverse effects possibly related to node dissection will be assessed at per-operative timepoint, in particular: - vascular (including blood loss) - urinary - digestive - and nervous system related disorders, Early post-operative morbidity possibly related to node dissection will be assessed up to 30 days and scored according to Clavien-Dindo scale: - post-operative complications (vascular, urinary, digestive, nervous complications), - symptomatic lymphocysts (necessitating pain killers or punctions) and leg lymphedemas whatever the intensity and duration (preoperative and postoperative legs and thigh measurements. Post-operative events of grade II or more defined by Clavien-Dindo scale, Distant complications, beyond day 30 for patients (e.g. secondary paraaortic dissection for pelvic pN1) will be evaluated in accordance with the NCI-CTCAE scale v4.03, until third year of post-operative follow-up. Adverse effects related to node dissection will be searched for, especially: - nervous complications (obturator, femoral nerves) - lymphatic (lymphocyst, leg lymphedema, erysipelas) complications. Concerning lymphocyst, only symptomatic lymphocysts (pain, fever...)
Endpoint(s): In the experimental arm (SN policy), the overall detection rate of pelvic SN (uni- or bilateral) is calculated as the number of patients with at least one SN detected per-operatively, divided by the total number of patients who underwent staging in the experimental arm. Bilateral detection rate is calculated as number of patients with bilateral SN divided by the total number of patients who underwent staging., SN-positive detection rate is calculated as number of detected SN divided by the total number of lymph nodes extracted, The disease free survival is defined as the time from the date of randomization to the first documentation of local, regional or distant relapse or all-cause death, whichever occurs first. Observations will be censored at the date of last follow-up for patients alive free of disease at last follow-up., The overall survival is defined as the time from the date of randomization to the date of all-cause death. Observations will be censored at the date of last follow-up for patients still alive. The specific survival is defined as the time from the date of randomization to the date of death from cancer. Observations will be censored at the date of death for patients who died from another cause, and at the date of last follow-up for patients still alive., Exploratory : standard staining with HES (hematoxylin-eosin-safran) is carried out in a systematic manner as well as immunohistochemistry with polyclonal anti-L1CAM: clone CD171 (SIGMA). The rate of L1CAM positive sample must be precised in the final pathology report, to be further correlated with the node involvement and disease recurrence., Exploratory: Standard sections of SN, with IHC staining or not, are required for mass spectrometry analysis. For each tissue, 7 superfrost slides are needed with 2 or 3 sections by glass slide (depending to the size of the tissue). All SN slides must be stored by the investigational site until their transfer to PRISM laboratory. During the study, the sponsor will draft the list of samples to be analyzed, and will organize shipment of slides from the investigational site, to the PRISM laboratory.

Source: https://euclinicaltrials.eu/ctis-public/view/2024-513079-42-00